EU clinical trial 2026-525540-15-00: Evaluation of the Non-Inferiority of Topical Chloramphenicol Versus Topical Ciprofloxacin in the Resolution of Otorrhea in Adults With Chronic Suppurative Otitis Media (CSOM) – Protocol OMCOS
Protocol code: OMCOS
Sponsor: Institut De Recerca Biomedica De Lleida Fundacio Dr. Pifarre (Laboratory/Research/Testing facility). Phase: Therapeutic confirmatory (Phase III). Countries: Spain (authorised, recruitment pending).
Therapeutic area(s): Diseases [C] - Otorhinolaryngologic Diseases [C09]
Gender: Female, Male. Age: 18-64 years, 65+ years. Enrolment: 88.
Status: Authorised, recruitment pending. Decision date: 2026-06-11. Results received: No. Last updated: 2026-06-12.
Decision dates by country: ES: 2026-06-12

Condition(s): chronic suppurative otitis media (CSOM)
Product: Cetraxal ótico 3 mg/ml gotas óticas en solución., CHLORAMPHENICOL

Primary endpoint: Proportion of patients with complete resolution of otorrhoea at Day 14, assessed by otoscopy/endoscopy performed by at least two otolaryngologists with digital photographic records.
Endpoint(s): Change in auditory thresholds (measured in dB) from baseline (Day 1) to Day 14, assessed via pure-tone audiometry., Incidence, type, and severity of local or systemic adverse events (e.g., local irritation, pruritus, otalgia) reported throughout the study period., Treatment adherence rate at Day 14, defined as the proportion of unused medication (vial count) and verified by patient self-reporting in the treatment diary., Patient-reported quality of life and therapeutic satisfaction scores at Day 14, measured using a validated CSOM-specific questionnaire., Comparative efficacy and safety outcomes at Day 14 and final analysis, stratified by patient gender.

Source: https://euclinicaltrials.eu/ctis-public/view/2026-525540-15-00